EU clinical trial 2025-523075-32-00: FINE-START; A parallel-group, randomized, prospective, interventional, double-blind, multicenter global Phase 3 study to investigate the efficacy and safety of finerenone versus placebo, in participants with chronic kidney disease not using renin-angiotensin-system inhibitors
Protocol code: 22817
Sponsor: Universitair Medisch Centrum Groningen (Hospital/Clinic/Other health care facility). Phase: Therapeutic confirmatory (Phase III). Countries: Spain (ongoing, recruiting).
Therapeutic area(s): Diseases [C] - Nutritional and Metabolic Diseases [C18]
Gender: Female, Male. Age: 18-64 years, 65+ years. Enrolment: 55.
Status: Ongoing, recruiting. Start date (EU): 2026-03-09. Decision date: 2025-12-15. Results received: No. Last updated: 2025-12-15.

Condition(s): chronic kidney disease
Product: Placebo for BAY 94-8862, BAY 94-8862, Finerenone

Primary endpoint: Change in UACR from baseline (ratio to baseline) over 6 months
Endpoint(s): Number of participants with TEAEs, TESAEs, Number of participants with Hyperkalemia (AESI)

Source: https://euclinicaltrials.eu/ctis-public/view/2025-523075-32-00